EU clinical trial 2025-523895-22-00: A Phase II, Multicenter, Open-Label Trial of DB-1311 in combination with BNT327 or DB-1305 in Participants with Advanced/Metastatic Solid Tumors
Protocol code: DB-1311-201
Sponsor: Dualitybio Inc. (Pharmaceutical company). Phase: Therapeutic exploratory (Phase II). Countries: Italy (authorised, recruitment pending), Poland (authorised, recruitment pending), France (authorised, recruitment pending), Spain (authorised, recruitment pending), Germany (authorised, recruitment pending).
Therapeutic area(s): Diseases [C] - Neoplasms [C04]
Gender: Female, Male. Age: 18-64 years, 65+ years. Enrolment: 102.
Status: Authorised, recruitment pending. Decision date: 2026-05-12. Results received: No. Last updated: 2026-05-15.
Decision dates by country: FR: 2026-05-13, DE: 2026-05-12, IT: 2026-05-12, ES: 2026-05-14, PL: 2026-05-15

Condition(s): Non-small cell lung cancer (NSCLC), Cervical cancer (CC), Melanoma, Hepatocellular carcinoma (HCC), Ovarian cancer (OC), Squamous cell carcinoma of head and neck
Product: BNT324, BNT325/DB-1305, BNT327

Primary endpoint: Part 1: Number of participants with Dose Limiting Toxicities (DLTs), Part 1: Treatment emergent adverse events (TEAEs) and treatment emergent serious AE (TESAEs), Part 2: ORR, defined as the proportion of participants in whom a confirmed CR or PR is observed as best overall response (per RECIST v1.1 based on the investigator’s assessment)., Part 2: Safety and tolerability: TEAEs and TESAEs
Endpoint(s): Part 1: Efficacy evaluations: objective response rate (ORR), defined as the proportion of participants in whom a confirmed CR or PR is observed as best overall response (per Response Evaluation Criteria in Solid Tumors version 1.1 [RECIST v1.1] based on the investigator’s assessment), Part 1: Duration of response (DoR), disease-control rate (DCR), Time to Response (TTR), Progression Free Survival (PFS) will be determined from tumor assessments by Investigator per RECIST v1.1., Part 1: Cancer antigen 125 (CA-125) response rate assessed per Gynecological Cancer Intergroup (GCIG) criteria in participants with platinumresistant ovarian cancer (PROC)., Part 1: Overall Survival (OS), Part 1: PK parameters of DB-1311 antibody-drug conjugate (ADC), total antibody, and unconjugated P1021 in combination with BNT327 or in combination with DB-1305., Part 1: Anti-drug antibody (ADA) prevalence: the proportion of participants who are ADA positive at any point in time (at baseline and post-baseline). ADA incidence: the proportion of participants having treatment-emergent ADA., Part 2: DoR, DCR, TTR, and PFS determined by Investigator as per RECIST v1.1, Part 2: Safety and tolerability: TEAEs and TESAEs, Part 2: OS, Part 2: PK parameters of DB-1311 ADC, total anti-B7H3 antibody, and unconjugated P1021., Part 2: ADA prevalence: the proportion of participants who are ADA positive at any point in time (at baseline and post-baseline). ADA incidence: the proportion of participants having treatment-emergent ADA.

Source: https://euclinicaltrials.eu/ctis-public/view/2025-523895-22-00